EU clinical trial 2023-505945-19-00: Multicenter phase 1b/II trial testing neoadjuvant intradermal Ipilimumab and Nivolumab in high risk stage II melanoma –MARIANE
Protocol code: M23MAR
Sponsor: Het Nederlands Kanker Instituut-Antoni van Leeuwenhoek Ziekenhuis Stichting (Hospital/Clinic/Other health care facility). Phase: Therapeutic exploratory (Phase II). Countries: Netherlands (ongoing, recruiting), Germany (ended), Sweden (authorised, recruitment pending).
Therapeutic area(s): Diseases [C] - Skin and Connective Tissue Diseases [C17]
Gender: Female, Male. Age: 18-64 years, 65+ years. Enrolment: 90.
Start date (EU): 2024-03-08. Decision date: 2024-02-05. Results received: No. Last updated: 2026-04-24.
Decision dates by country: DE: 2025-06-25, NL: 2024-02-05, SE: 2025-06-13

Condition(s): stage II melanoma

Source: https://euclinicaltrials.eu/ctis-public/view/2023-505945-19-00